EU clinical trial 2023-508276-11-00: A Phase III Multi-center, Open-label, Sponsor-blinded, Randomized Study of AZD0901 Monotherapy Compared With Investigator’s Choice of Therapy in Second- or Later-Line Adult Participants with Advanced/Metastatic Gastric or Gastroesophageal Junction Adenocarcinoma Expressing Claudin 18.2 (CLARITY-Gastric 01)
Protocol code: D9802C00001
Sponsor: AstraZeneca AB (Pharmaceutical company). Phase: Therapeutic confirmatory (Phase III). Countries: Germany (ongoing, recruitment ended), Poland (ongoing, recruitment ended), France (ongoing, recruitment ended), Italy (ongoing, recruitment ended), Spain (ongoing, recruitment ended).
Therapeutic area(s): Diseases [C] - Neoplasms [C04]
Gender: Female, Male. Age: 18-64 years, 65+ years. Enrolment: 91.
Status: Ongoing, recruitment ended. Start date (EU): 2025-01-17. Decision date: 2024-07-25. Results received: No. Last updated: 2026-06-10.
Decision dates by country: PL: 2024-07-29, ES: 2025-03-20, FR: 2024-07-29, IT: 2024-07-26, DE: 2024-07-25

Condition(s): Gastric cancer, Advanced/Metastatic Gastric cancer, Gastroesophageal Junction Adenocarcinoma Expressing Claudin18.2
Product: Cyramza 10 mg/ml concentrate for solution for infusion, Irinotecan Bendalis 20 mg/ml Konzentrat zur Herstellung einer Infusionslösung, Lonsurf 20 mg/8.19 mg film-coated tablets, Paclitaxel Bendalis 6 mg/ml Konzentrat zur Herstellung einer Infusionslösung, Lonsurf 15 mg/6.14 mg film-coated tablets, Docetaxel Hikma 80 mg/4 ml Konzentrat zur Herstellung einer Infusionslösung, AZD0901, Bendadocel 20 mg/ml Konzentrat zur Herstellung einer Infusionslösung, Irinotecan Accord, 20 mg/ml, koncentrat do sporządzania roztworu do infuzji

Primary endpoint: PFS in all randomized participants (BICR), OS for 3L+ participants
Endpoint(s): OS in all - time from randomization until the date of death due to any cause., PFS for 3L+ participants- time from randomization until progression per RECIST 1.1 asassessed by BICR or death due to any cause., ORR in all- the proportion of participants with at least one visit response of confirmed CR or confirmed PR, as determined by BICR per RECIST 1.1., ORR for 3L+ participants, DoR in all- the time from the date of first documented confirmed response until date of documented progression per RECIST 1.1 as assessed by BICR or death due to any cause., DoR for 3L+ participants, Serum concentrations of AZD0901, total antibody and MMAE, and PK parameters, Presence of ADAs against AZD0901 in serum, Incidence of AEs and SAEs.

Source: https://euclinicaltrials.eu/ctis-public/view/2023-508276-11-00